EU clinical trial 2025-521639-34-00: A Phase I, Multicentre, Dose Escalation and Dose Expansion Study to Investigate the Pharmacokinetics and Safety of Subcutaneous Durvalumab in Adult Participants with Solid Tumours (IMFINZI-subQ)
Protocol code: D907HC00001
Sponsor: AstraZeneca AB (Pharmaceutical company). Phase: Human Pharmacology (Phase I)- Other. Countries: Poland (authorised, recruiting).
Therapeutic area(s): Diseases [C] - Neoplasms [C04]
Gender: Female, Male. Age: 18-64 years, 65+ years. Enrolment: 4.
Status: Authorised, recruiting. Start date (EU): 2026-04-20. Decision date: 2026-03-27. Results received: No. Last updated: 2026-07-06.

Condition(s): • Non-small cell lung cancer (Stage III, unresectable); • Small cell lung cancer (Limited stage); • Hepatocellular carcinoma (Unresectable)
Product: IMJUDO 20 mg/ml concentrate for solution for infusion., AZD4773, MYCOPHENOLATE MOFETIL, IMFINZI 50 mg/mL concentrate for solution for infusion, INFLIXIMAB

Primary endpoint: AUC and Ctrough
Endpoint(s): Other PK parameters (including Ctrough, AUClast, Cmax, tmax, t1/2λz, CL(/F),Vz(/F), and Cavg) and serum durvalumab concentrations at specified timepoints., DLT assessment, AEs (including SC site of administration-related AEs), physical examination, clinical laboratory assessments, vital signs, and ECOG performance status.

Source: https://euclinicaltrials.eu/ctis-public/view/2025-521639-34-00